EU clinical trial 2025-524511-36-00: Impact of epilepsy on the brainstem adenosine pathway and its relation with arousal and respiratory reactivity BRAVE
Protocol code: 69HCL25_0757
Sponsor: Hospices Civils De Lyon (Hospital/Clinic/Other health care facility). Phase: Therapeutic exploratory (Phase II). Countries: France (authorised, recruitment pending).
Therapeutic area(s): Diseases [C] - Nervous System Diseases [C10]
Gender: Female, Male. Age: 18-64 years. Enrolment: 50.
Status: Authorised, recruitment pending. Decision date: 2026-04-30. Results received: No. Last updated: 2026-04-30.

Condition(s): Neurology
Product: [18F]CPFPX

Primary endpoint: Comparison of the [18F]-CPFPX BPND in the brainstem structures involved in respiratory regulation under hypercapnic condition in patients with drug-resistant epilepsy with the one of healthy subjects
Endpoint(s): Comparison of the [18F]-CPFPX BPND in the cortical structures involved in respiratory regulation under hypercapnic condition in patients with drug-resistant epilepsy with the one of healthy subjects, Evaluating the relation between [18F]-CPFPX BPND in the brainstem structures involved in respiratory regulation under hypercapnic condition and the HCVR slope in patients with drug-resistant epilepsy and in healthy subjects, Comparison of the HCVR slope in patients with drug-resistant epilepsy and in heathly subjects, Evaluating the relation between the HCVR slope and the pattern of BOLD activiation during BH in patients with drug-resistant epilepsy and in heathly subjects, Comparing brainstem regional volumes on MRI of patients with drug-resistant epilepsy with the one of healthy subjects, Evaluating the relation between the brainstem regional volumes on MRI and the HCVR slope in patients with drug-resistant epilepsy and in heathly subjects, Evaluating the relation between mean daily intake of caffeine (mg/day) and the [18F]-CPFPX BPND in the brainstem and cortical structures

Source: https://euclinicaltrials.eu/ctis-public/view/2025-524511-36-00